EU clinical trial 2022-501802-36-00: ARTEMIS: RAvulizumab to PRotect PaTients with Chronic Kidney DisEase (CKD) froM Cardiac Surgery Associated Acute Kidney Injury (CSA-AKI) and Subsequent Major Adverse Kidney Events (MAKE): A Phase 3, Randomized, Double-blind, Placebo-controlled, Multicenter Study
Protocol code: ALXN1210-CSA-AKI-318
Sponsor: Alexion Pharmaceuticals Inc. (Pharmaceutical company). Phase: Therapeutic confirmatory (Phase III). Countries: Italy (ended), Germany (ended), Poland (ended), Spain (ended), Netherlands (ended), France (ended), Portugal (ended), Greece (ended).
Therapeutic area(s): Diseases [C] - Pathological Conditions, Signs and Symptoms [C23]
Gender: Female, Male. Age: 18-64 years, 65+ years. Enrolment: 270.
Status: Ended. Start date (EU): 2023-06-16. End date (EU): 2026-04-29. End date: 2026-04-30. Decision date: 2023-05-15. Results received: No. Last updated: 2025-07-17.
Decision dates by country: PL: 2023-05-22, DE: 2023-05-15, ES: 2023-05-23, FR: 2024-11-26, NL: 2023-12-08, IT: 2023-05-16, PT: 2025-07-17, GR: 2025-07-11

Condition(s): Prevention of cardiac surgery associated acute kidney injury
Product: Anti C5 Complement mAb Placebo, Ultomiris 300 mg/30 mL concentrate for solution for infusion

Primary endpoint: MAKE90 defined as meeting at least 1 of the following criteria: o Decrease from baseline in eGFR (CKD-EPI formula using sCysC) of ≥ 25% at Day 90 post CPB, or o Initiation of KRT through Day 90 post CPB, or o Death from any cause through Day 90 post CPB
Endpoint(s): 1) Occurrence of CSA-AKI without recovery at Day 90 post CPB, 2) Occurrence of severe CSA-AKI (KDIGO Stage 2 or 3) from randomization to Day 7 post CPB, 3) Occurrence of severe AKI (KDIGO Stage 2 or 3) from randomization to Day 30 post CPB, 6) Length of post-operative ICU stay, 4) Occurrence of KRT or death from randomization to Day 90 post CPB, 5) All-cause mortality from randomization to Day 90 post CPB, MAKE and its components at Days 30, 60 and 90 post CPB (excluding MAKE90 based on sCysC), Occurrence of KRT or death by Days 30 and 60 Post CPB, Highest CSA-AKI stage within 3 and 7 days post CPB, Occurrence of CSA-AKI without recovery at Day 15, 30 and 60 post CPB, Occurrence of AKI at Days 3, 7, 15, 30, 60, and 90 post CPB, AKI Progression on Days 15, 30, 60, and 90 post CPB for those experiencing CSA-AKI within 7 days post CPB: • Complete recovery • Partial recovery • Improvement • Stable • Worsening, • Length of post-operative hospital stay • Number of days on ventilator through Day 30 and Day 90 post CPB; • Hospital readmission rate (all-cause or AKI-related) through Day 30 and Day 90 post CPB; • Days on KRT through Day 30 and Day 90 post CPB, Change from baseline in KDQOL-36™ at Days 30, 60, and 90 post CPB; Change from baseline in EQ-5D-5L at Days 30, 60, and 90 post CPB; Change from baseline in FACIT-Fatigue at Days 30, 60, and 90 post CPB, Serum concentrations of ravulizumab; Absolute values, change from baseline and percent change from baseline in serum free C5 concentrations, • TEAEs and TESAEs; • Change from baseline in laboratory parameters at scheduled visits, ADA status, ADA response categories, and titer at Day 90 post CPB, Occurrence of post-operative Renal Failure (STS metric based on RIFLE Failure creatinine criteria)

Source: https://euclinicaltrials.eu/ctis-public/view/2022-501802-36-00